EU clinical trial 2024-519687-40-00: A comparison of the effect of autologous bone marrow-derived mononuclear cell therapy with standard treatment on ischemia parameters in diabetic patients with chronic limb-threatening ischemia
Protocol code: BMMNC_CLI_002
Sponsor: Institute For Clinical And Experimental Medicine (Hospital/Clinic/Other health care facility). Phase: Phase II and Phase III (Integrated). Countries: Czechia (ongoing, recruiting).
Therapeutic area(s): Diseases [C] - Digestive System Diseases [C06]
Gender: Female, Male. Age: 18-64 years, 65+ years. Enrolment: 60.
Status: Ongoing, recruiting. Start date (EU): 2020-09-11. Decision date: 2025-01-13. Results received: No. Last updated: 2025-01-13.

Condition(s): diabetic foot syndrome, lower limb ischemia
Product: Suspension of autologous mononuclear cells separated from bone marrow aspirate

Primary endpoint: Comparison of cell therapy with standard treatment in several parameters: Assessment of tissue oxygenation – improvement of parameters of ischemia (measured by transcutaneous oxygen pressure andoptionally by other angiological methods), Comparison of cell therapy with standard treatment in several parameters: Clinical effect – wound healing, change in pain, rate of major amputation, amputation-free survival
Endpoint(s): Safety: adverse events - expected and unexpected, Assesment of study treatment by patients (psychological questionaries), To assess the relation between the quality of cell suspension and tissue oxygenation

Source: https://euclinicaltrials.eu/ctis-public/view/2024-519687-40-00